EU clinical trial 2023-506247-42-00: A Study to Examine the Effects of Novel Therapy Linvoseltamab in Combination With Other Cancer Treatments for Adult Patients With Multiple Myeloma That is Resistant to Current Standard of Care Treatments
Protocol code: R5458-ONC-2012
Sponsor: Regeneron Pharmaceuticals Inc. (Pharmaceutical company). Phase: Human Pharmacology (Phase I)- Other. Countries: Greece (ongoing, recruiting), France (ongoing, recruiting), Spain (ongoing, recruiting), Netherlands (authorised, recruitment pending).
Therapeutic area(s): Diseases [C] - Neoplasms [C04]
Gender: Female, Male. Age: 18-64 years, 65+ years. Enrolment: 309.
Start date (EU): 2022-08-17. Decision date: 2024-06-27. Results received: No. Last updated: 2026-06-29.
Decision dates by country: ES: 2024-06-27, GR: 2024-08-07, FR: 2024-07-02, NL: 2026-03-06

Condition(s): Relapsed/Refractory Multiple Myeloma

Source: https://euclinicaltrials.eu/ctis-public/view/2023-506247-42-00